EU clinical trial 2022-501415-14-00: Double-blind, randomised clinical study comparing efficacy and safety of Mecloderm® Ointment (Test) vs. Lotricomb® Ointment (Reference) vs. Vehicle in patients with moderate to severely inflamed candidiasis of the skin
Protocol code: 21-01/ClotriBet-S
Sponsor: Dermapharm AG (Pharmaceutical company). Phase: Therapeutic confirmatory (Phase III). Countries: Germany (ongoing, recruiting).
Therapeutic area(s): Diseases [C] - Skin and Connective Tissue Diseases [C17]
Gender: Female, Male. Age: 18-64 years, 65+ years. Enrolment: 552.
Status: Ongoing, recruiting. Start date (EU): 2022-03-08. Decision date: 2024-05-15. Results received: No. Last updated: 2026-05-18.

Condition(s): moderate to severely inflamed candidiasis of the skin
Product: Vehicle to Mecloderm Ointment, LOTRICOMB® Salbe, 0,64 mg/g + 10 mg/g, Salbe, Mecloderm Ointment

Primary endpoint: Number (percentage) of patients with treatment success (defined as sum score of clinical parameters ≤ 2 and all individual score values ≤ 1 and negative mycological result) at the main examination (EOT visit 3 after 14 days).
Endpoint(s): Change of the sum score of clinical parameters between baseline and follow-up visits, and between main examination (EOT) and final examination, Number (percentage) of patients with mycological success (negative mycological cultivation and/or negative microscopical result) at visit 3 (EOT) and at the final visit (visit 4), Evaluation of therapeutic success at visit 2 and EOT by the investigator and by the patient, Evaluation of overall therapeutic success by the investigator at the final examination, Number (percentage) of patients with clinical relapse/re-infection at the final examination visit

Source: https://euclinicaltrials.eu/ctis-public/view/2022-501415-14-00